EU clinical trial 2025-524308-31-00: A Phase II, Open-Label Randomized Study of Intravenous Tambiciclib in Combination with the Standard of care Venetoclax and Azacitidine in Patients with Newly Diagnosed AML Who Failed to Achieve at Least MLFS After the First Two Cycles of Treatment with Venetoclax and Azacitidine Alone
Protocol code: IRST204.09
Sponsor: Istituto Romagnolo Per Lo Studio Dei Tumori Dino Amadori IRST S.r.l., IIS La Fe (Hospital/Clinic/Other health care facility, Laboratory/Research/Testing facility). Phase: Therapeutic exploratory (Phase II). Countries: Italy (authorised, recruitment pending), Spain (authorised, recruitment pending).
Therapeutic area(s): Diseases [C] - Neoplasms [C04]
Gender: Female, Male. Age: 18-64 years, 65+ years. Enrolment: 40.
Status: Authorised, recruitment pending. Decision date: 2026-05-19. Results received: No. Last updated: 2026-06-11.
Decision dates by country: IT: 2026-05-19, ES: 2026-06-11

Condition(s): Acute myeloid leukemia
Product: VENETOCLAX, TAMBICICLIB 100 mg/20 mL, Solution for Injection, AZACITIDINE, TAMBICICLIB 100 mg/10 mL, Solution for Injection

Primary endpoint: Difference in Overall response rate (ORR) at course 2 defined as Complete response (CR) rate + Complete hematological response (CRh) + complete response with incomplete hematologic recovery (CRi) rate + Morphologic leukemia free state (MLFS) rate according ELN 2022 definition.
Endpoint(s): Proportion of patients experiencing adverse events (AE) and severe adverse events (SAE) graded according to NCI-CTCAE 5.0., Event-free survival defined as time from C1D1 to treatment failure, relapse or death from any reason. Treatment failure is defined as lack of response (no achievement of at least MLFS) after second treatment cycle., Overall survival defined as time from C1D1 to death from any reason.

Source: https://euclinicaltrials.eu/ctis-public/view/2025-524308-31-00